EU clinical trial 2024-512865-15-00: A PHASE 2, RANDOMIZED, BLINDED, PLACEBOCONTROLLED, STUDY TO EVALUATE SAFETY, TOLERABILITY, PHARMACOMETRICS, AND EFFICACY OF DNTH103 IN ADULTS WITH GENERALIZED MYASTHENIA GRAVIS (MAGIC)
Protocol code: DNTH103-MG-201
Sponsor: Dianthus Therapeutics Inc. (Laboratory/Research/Testing facility). Phase: Therapeutic exploratory (Phase II). Countries: Denmark (ongoing, recruitment ended), Poland (ongoing, recruitment ended), France (ended), Netherlands (ended), Norway (ended), Italy (ongoing, recruitment ended), Czechia (ongoing, recruitment ended), Sweden (ended), Spain (ended).
Therapeutic area(s): Diseases [C] - Immune System Diseases [C20]
Gender: Female, Male. Age: 18-64 years, 65+ years. Enrolment: 54.
Start date (EU): 2024-09-03. Decision date: 2024-07-22. Results received: No. Last updated: 2026-04-22.
Decision dates by country: FR: 2024-08-15, SE: 2024-08-15, NL: 2024-08-15, NO: 2024-08-15, ES: 2025-02-28, DK: 2024-07-22, PL: 2024-08-15, CZ: 2024-08-15, IT: 2024-08-15

Condition(s): Generalized Myasthenia Gravis
Product: Placebo to match DNTH103, Nimenrix powder and solvent for solution for injection in pre-filled syringe Meningococcal groups A, C, W-135 and Y conjugate vaccine, DNTH103, Bexsero suspension for injection in pre-filled syringe Meningococcal group B Vaccine (rDNA, component, adsorbed), Nimenrix powder and solvent for solution for injection in pre-filled syringe Meningococcal groups A, C, W-135 and Y conjugate vaccine, Bexsero suspension for injection in pre-filled syringe Meningococcal group B Vaccine (rDNA, component, adsorbed), Nimenrix powder and solvent for solution for injection in pre-filled syringe Meningococcal groups A, C, W-135 and Y conjugate vaccine, Nimenrix powder and solvent for solution for injection in pre-filled syringe Meningococcal groups A, C, W-135 and Y conjugate vaccine, Bexsero suspension for injection in pre-filled syringe Meningococcal group B Vaccine (rDNA, component, adsorbed), Bexsero suspension for injection in pre-filled syringe Meningococcal group B Vaccine (rDNA, component, adsorbed)

Primary endpoint: Safety and tolerability of DNTH103 up to Week 13: Incidence of TEAEs and treatment-emergent SAEs up to Week 13 (end of the RCT period)
Endpoint(s): Efficacy: Change from baseline to Week 13 in MG-ADL scale score, Efficacy: Change from baseline to Week 13 in Quantitative Myasthenia Gravis (QMG) scale score, Efficacy: Change from baseline to Week 13 in Myasthenia Gravis Composite (MGC) scale score, Pharmacokinetics/Pharmacodynamics: Serum concentrations and PK parameters, including Cmax and Cmin, Pharmacokinetics/Pharmacodynamics: PD parameters (eg, CH50 [complement hemolysis 50%]) in serum ex vivo, Immunogenicity: Incidence and titer of antidrug antibodies against DNTH103levels against DNTH103, Safety and tolerability over 52 weeks in the OLE: Incidence of TEAEs and treatment-emergent SAEs up to Week 52 in the OLE

Source: https://euclinicaltrials.eu/ctis-public/view/2024-512865-15-00